EU clinical trial 2024-513281-19-00: Study of safety and efficacy of DKY709 alone or in combination with PDR001 in patients with advanced solid tumors.
Protocol code: CDKY709A12101C
Sponsor: Novartis Pharma AG (Pharmaceutical company). Phase: Human Pharmacology (Phase I)- First administration to humans. Countries: Spain (ongoing, recruitment ended), Germany (ongoing, recruitment ended).
Therapeutic area(s): Diseases [C] - Neoplasms [C04]
Gender: Female, Male. Age: 18-64 years, 65+ years. Enrolment: 32.
Status: Ongoing, recruitment ended. Start date (EU): 2024-11-25. Decision date: 2024-08-08. Results received: No. Last updated: 2026-06-12.
Decision dates by country: ES: 2024-08-08, DE: 2024-08-09

Condition(s): Non-Small Cell Lung Cancer, Nasopharyngeal Carcinoma, Cutaneous Melanoma, Microsatellite Stable Colorectal Cancer, Triple Negative Breast Cancer

Source: https://euclinicaltrials.eu/ctis-public/view/2024-513281-19-00